EU clinical trial 2023-510380-34-00: A Phase II, multi-part, five-year, randomized, open-label, assessor-blinded, active-controlled, multicenter study to evaluate the efficacy and safety of rapcabtagene autoleucel versus rituximab treatment in participants with severe refractory diffuse cutaneous systemic sclerosis
Protocol code: CYTB323K12201
Sponsor: Novartis Pharma AG (Pharmaceutical company). Phase: Therapeutic exploratory (Phase II). Countries: Italy (ongoing, recruiting), Spain (ongoing, recruiting), France (ongoing, recruiting), Netherlands (ongoing, recruiting), Germany (ongoing, recruiting), Austria (ongoing, recruiting), Czechia (ongoing, recruiting), Belgium (ongoing, recruiting), Denmark (ongoing, recruiting), Hungary (ongoing, recruiting), Poland (authorised, recruitment pending).
Therapeutic area(s): Diseases [C] - Immune System Diseases [C20]
Gender: Female, Male. Age: 18-64 years, 65+ years. Enrolment: 82.
Start date (EU): 2024-12-10. Decision date: 2024-10-02. Results received: No. Last updated: 2026-07-06.
Decision dates by country: CZ: 2025-02-27, HU: 2025-03-10, BE: 2025-02-27, FR: 2024-12-04, AT: 2025-02-23, DK: 2025-02-10, ES: 2024-12-02, IT: 2024-10-02, NL: 2024-10-07, PL: 2026-07-06, DE: 2024-10-04

Condition(s): Diffuse cutaneous systemic sclerosis (dcSSc)
Product: CYCLOPHOSPHAMIDE, TOCILIZUMAB, RITUXIMAB, RITUXIMAB, FLUDARABINE PHOSPHATE, YTB323

Primary endpoint: Achievement of a treatment response as per the rCRISS50 definition at Week 52
Endpoint(s): Change from baseline in FVC% predicted at Week 52, Change from baseline in mRSS at Week 52, Change from baseline in HAQ-DI at Week 52, Safety evaluation includes adverse events, laboratory parameters, vital signs, ECGs, and mortality

Source: https://euclinicaltrials.eu/ctis-public/view/2023-510380-34-00